EU clinical trial 2025-524378-40-00: Phase II Clinical Trial of KORTUC (KRC-01) Combined with Radiotherapy for Locally Advanced Rectal Cancer: Towards a New Organ Preservation Approach (K-BOOST)
Protocol code: 2025/4237 K-BOOST
Sponsor: Institut Gustave Roussy (Hospital/Clinic/Other health care facility). Phase: Therapeutic exploratory (Phase II). Countries: France (authorised, recruitment pending).
Therapeutic area(s): Diseases [C] - Neoplasms [C04]
Gender: Female, Male. Age: 18-64 years, 65+ years. Enrolment: 24.
Status: Authorised, recruitment pending. Decision date: 2026-05-28. Results received: No. Last updated: 2026-05-29.
Decision dates by country: FR: 2026-05-29

Condition(s): Locally advanced high‑risk stage III rectal adenocarcinoma (non‑metastatic)
Product: KRC-01

Primary endpoint: Clinical Complete Response (cCR) rate at week 24
Endpoint(s): OS defined as the time from inclusion until death from any cause. Patients who are alive at last follow-up news will be censored at this date., PFS defined as the time from inclusion until first documentation of progression or death, whichever occurs first., The percentage of patient with pCR defined as the complete absence of viable tumor cells, or the major pathologic response (MPR) defined as less than 10% of surviving tumor cells in in the surgical specimen., The incidence of adverse events (AEs) NCI-CTCAE v6.0, Scores from EORTC QLQ-C30 and EQ-5D-5L questionnaires at baseline, Week 6 and Week 24., Identification of predictive and prognostic biomarkers of treatment response (circulating and tumor-derived)., Correlation between radiological response (RECIST) and metabolic response (PET imaging)., Characterization of systemic and intratumoral immune modulation induced by KRC-01 and chemotherapy (flow cytometry, immunohistochemistry, single-cell RNAseq), Evaluation of circulating biomarkers (e.g., ctDNA, cytokines) and correlation with clinical response, Analysis of gut microbiome modifications during treatment and association with therapeutic outcomes., Longitudinal assessment of patient-reported quality of life and symptom burden throughout treatment and follow-up.

Source: https://euclinicaltrials.eu/ctis-public/view/2025-524378-40-00